EU clinical trial 2025-524358-32-00: PAROCAINE : Evaluation of the Clinical Tolerance of an Intra-Parotid Injection of Bupivacaine Combined with Dexamethasone After Parotidectomy for a Benign Tumor – Prospective Single-Center Cohort Study
Protocol code: LOCAL/2025/BL01
Sponsor: Centre Hospitalier Universitaire De Nimes (Hospital/Clinic/Other health care facility). Phase: Therapeutic exploratory (Phase II). Countries: France (ongoing, recruiting).
Therapeutic area(s): Diseases [C] - Otorhinolaryngologic Diseases [C09]
Gender: Female, Male. Age: 18-64 years, 65+ years. Enrolment: 10.
Status: Ongoing, recruiting. Start date (EU): 2026-06-12. Decision date: 2026-03-19. Results received: No. Last updated: 2026-03-19.

Condition(s): Indication opératoire validée de parotidectomie partielle pour tumeur parotidienne
Product: DEXAMETHASONE, BUPIVACAINE

Primary endpoint: Collection within 15 days of injection of any local side effects related to the injection of bupivacaine.
Endpoint(s): Pain level (VAS 0-10) on D0, D1, D2, D4, D6, D9, D12, and at the D15 consultation., Collection of data on the occurrence of salivary fistula or clinical sialoma at the post-operative consultation on D15 : yes/no., Administration of a questionnaire on the quality of healing (dehiscence, inflammation, infection) at the 15-day follow-up., Feasibility questionnaire, to be completed by the surgeon on the day of surgery.

Source: https://euclinicaltrials.eu/ctis-public/view/2025-524358-32-00